EU clinical trial 2023-508339-29-00: Comparative Bioavailability of Ruxolitinib 20 mg Film-Coated Tablets: A Single-Dose, Open-Label, Randomized, Two-Treatment, Two-Sequence, Two-Period Crossover Study in Healthy Participants Under Fasting Conditions.
Protocol code: BLCL-RUX-PIL01
Sponsor: Bluepharma Industria Farmaceutica S.A. (Pharmaceutical company). Phase: Human Pharmacology (Phase I)- Bioequivalence Study. Countries: Portugal (ended).
Therapeutic area(s): Not possible to specify
Gender: Female, Male. Age: 18-64 years. Enrolment: 12.
Status: Ended. Start date (EU): 2023-12-26. End date (EU): 2024-02-05. Decision date: 2023-12-20. Results received: Yes. Last updated: 2024-01-18.

Condition(s): No medical condition.
Product: Ruxolitinib, Jakavi 20 mg tablets

Primary endpoint: Cmax and AUC0-t of Ruxolitinib will be the primary pharmacokinetic parameters.
Endpoint(s): tmax, AUC0-∞, %AUCextrap, λz and t1/2 of Ruxolitinib will be the socondary pharmacokinetic parameters., Occurrence of treatment-emergent adverse events (TEAEs), including clinically relevant abnormalities on vital signs or clinical laboratory tests.

Source: https://euclinicaltrials.eu/ctis-public/view/2023-508339-29-00